EU clinical trial 2023-505433-27-00: 18424-326: A Phase 3b, Double-Blind, Multicenter, Randomized, Vehicle-Controlled, Efficacy, and Safety Study of Ruxolitinib Cream in Adults With Moderate Atopic Dermatitis
Protocol code: INCB 18424-326
Sponsor: Incyte Corp. (Pharmaceutical company). Phase: Therapeutic confirmatory (Phase III). Countries: Spain (ended), Italy (ended), Poland (ended), Netherlands (ended), Germany (ended), Hungary (ended), Bulgaria (ended), Belgium (ended), France (ended).
Therapeutic area(s): Diseases [C] - Skin and Connective Tissue Diseases [C17]
Gender: Female, Male. Age: 18-64 years, 65+ years. Enrolment: 132.
Status: Ended. Start date (EU): 2024-08-13. End date (EU): 2025-10-17. End date: 2025-10-17. Decision date: 2024-07-23. Results received: No. Last updated: 2025-10-14.
Decision dates by country: FR: 2024-07-25, BE: 2024-08-07, IT: 2024-07-26, NL: 2024-07-23, DE: 2024-07-29, HU: 2024-07-29, PL: 2024-07-29, BG: 2024-08-05, ES: 2024-07-24

Condition(s): Atopic Dermatitis
Product: Vehicle cream: same formulation of cream as the test product but without active substance., Ruxolitinib (INCB018424) cream

Primary endpoint: Proportion of participants with EASI75 from baseline at Week 8. (EASI75 is defined as achieving ≥ 75% improvement in EASI score.) and Proportion of participants with IGA-TS at Week 8. (IGA-TS is defined as achieving an IGA score of 0 or 1 with ≥ 2-grade improvement from baseline.)
Endpoint(s): Proportion of participants with ITCH4 from baseline to Week 8. (ITCH4 is defined as achieving ≥ 4-point improvement in Itch NRS score.) and Proportion of participants with ITCH4 from baseline to Day 7. and Proportion of participants with ITCH4 from baseline to Day 3. and Proportion of participants with ITCH4 from baseline to Day 2., The type, frequency, and severity of AEs as well as changes from baseline in vital signs and laboratory data for hematology and serum chemistry., Proportion of participants with EASI75 from baseline at each postbaseline visit except Week 8. and Proportion of participants with IGA-TS from baseline at each postbaseline visit except Week 8. and Proportion of participants with ITCH4 from baseline at each postbaseline visit except Week 8. and Time to achieve ITCH4 during the VC period. and ime to achieve ITCH2 during the VC period. (ITCH2 is defined as achieving ≥ 2-point improvement from baseline in Itch NRS score.) etc., Proportion of participants who achieve ≥ 4-point improvement in DLQI from baseline at each postbaseline visit. and Change from baseline in the following scores at each postbaseline visit: − DLQI − POEM − EQ-5D-5L − HADS − PROMIS Short Form – Sleep-Related Impairment (8a – 7-day recall) − PROMIS Short Form – Sleep Disturbance (8b – 7-day recall) and Change from baseline score at Weeks 8 and 24 in WPAI-AD.

Source: https://euclinicaltrials.eu/ctis-public/view/2023-505433-27-00